EU clinical trial 2022-502286-16-00: A Randomized, Double-blind, Placebo-Controlled, Multicenter, Phase 3 Study to Evaluate the Safety, Tolerability, and Efficacy of XEN1101 as Adjunctive Therapy in Primary Generalized Tonic-Clonic Seizures (X-ACKT)
Protocol code: XPF-010-303
Sponsor: Xenon Pharmaceuticals Inc. (Pharmaceutical company). Phase: Therapeutic confirmatory (Phase III). Countries: Portugal (ongoing, recruiting), Spain (ended), Italy (authorised, recruiting), Austria (ongoing, recruiting), Czechia (ended), Poland (ongoing, recruiting), Croatia (ended), Bulgaria (ongoing, recruiting), Germany (ongoing, recruiting), Netherlands (authorised, recruiting), France (ongoing, recruiting), Belgium (ongoing, recruiting).
Therapeutic area(s): Diseases [C] - Nervous System Diseases [C10]
Gender: Female, Male. Age: 0-17 years, 18-64 years, 65+ years. Enrolment: 108.
Start date (EU): 2023-10-27. Decision date: 2023-06-16. Results received: No. Last updated: 2026-07-06.
Decision dates by country: HR: 2023-06-21, CZ: 2023-06-16, BE: 2024-06-14, FR: 2024-10-10, NL: 2024-07-12, PL: 2023-06-21, PT: 2023-06-19, IT: 2023-06-21, DE: 2024-07-01, AT: 2023-06-21, BG: 2023-06-21, ES: 2023-06-19

Condition(s): Primary Generalized Tonic-Clonic Seizures
Product: XEN1101 placebo drug product consists of a size 3 white opaque HPMC capsule (Capsugel VCaps® Plus White OP) containing 10mg of Avicel® PH102 (microscrystaline cellulose), XPF-010, XPF-010, XPF-010, XPF-010

Primary endpoint: Proportion of subjects experiencing ≥50% reduction in monthly (28 days) PGTCS frequency from baseline through the DBP for XEN1101 versus placebo
Endpoint(s): MPC in monthly (28 days) PGTCS frequency from baseline through the DBP for XEN1101 versus placebo, Proportion of subjects experiencing PGTCS freedom from baseline through the DBP for XEN1101 versus placebo., Proportion of subjects experiencing “At least much improved” (including “Much” and “Very much improved”) in PGI-C at Week 12.

Source: https://euclinicaltrials.eu/ctis-public/view/2022-502286-16-00